EU clinical trial 2023-508646-18-00: A 4-part, open-label, multicenter, multinational study of the safety, tolerability, pharmacokinetics, pharmacodynamic, and exploratory efficacy of venglustat in combination with Cerezyme in adult patients with Gaucher disease Type 3 with venglustat monotherapy extension
Protocol code: PDY13949
Sponsor: Genzyme Corp. (Pharmaceutical company). Phase: Therapeutic exploratory (Phase II). Countries: Germany (ended).
Therapeutic area(s): Diseases [C] - Congenital, Hereditary, and Neonatal Diseases and Abnormalities [C16]
Gender: Female, Male. Age: 18-64 years. Enrolment: 3.
Status: Ended. Start date (EU): 2017-09-18. End date (EU): 2025-09-02. Decision date: 2023-12-08. Results received: No. Last updated: 2025-08-28.

Condition(s): Gaucher disease type 3, Gaucher disease type 1
Product: venglustat GZ402671 - SAR402671, IMIGLUCERASE, venglustat GZ402671 - SAR402671

Primary endpoint: Number of participants with Treatment Emergent Adverse Events (TEAEs), Assessment of pharmacodynamic (PD) parameter: Lyso-glucosylceramide (lyso-GL1) and glucosylceramide (GL-1) in cerebrospinal fluid (CSF)
Endpoint(s): Assessment of pharmacodynamic (PD) parameter: Lyso-glucosylceramide (lyso-GL1) and glucosylceramide (GL-1) in plasma, Assessment of plasma pharmacokinetic parameter: Cmax (Part 2), Assessment of plasma pharmacokinetic parameter: Tmax (Part 2), Assessment of plasma pharmacokinetic parameter: AUC 0-24h (Part2), Assessment of plasma pharmacokinetic parameter: Ctrough, Assessment of CSF pharmacokinetic parameter: Cmax, Assessment of spleen volume, Assessment of spleen volume (Part4), Assessment of liver volume, Assessment of liver volume (Part 4), Assessment of hemoglobin level, Assessment of hemoglobin level (Part 4), Assessment of platelet level, Assessment of platelet level (Part 4), Assessment of Ataxia, Assessment of Ataxia (Part 4)

Source: https://euclinicaltrials.eu/ctis-public/view/2023-508646-18-00